EU clinical trial 2024-517956-36-00: A double blinded, balanced, randomized, two-treatment, two-period, two-sequence, single dose, crossover, bioequivalence study comparing Lisdexamfetamine Dimesylate capsules 10 mg, manufactured by Ohm Laboratories Inc. (A Sun Pharma Company), 14 Terminal Road, New Brunswick, 08901, NJ, USA with Vyvanse (Lisdexamfetamine Dimesylate) 10 mg capsules; Product of Takeda Canada Inc., Toronto Ontario ON M5H 4E3, Canada, in healthy adult, human subjects under fasting condition.
Protocol code: LISDE-14-24
Sponsor: Sun Pharmaceutical Industries Limited (Pharmaceutical company). Phase: Human Pharmacology (Phase I)- Bioequivalence Study. Countries: Romania (authorised, recruitment pending).
Therapeutic area(s): Diseases [C] - Nervous System Diseases [C10]
Gender: Female, Male. Age: 18-64 years. Enrolment: 64.
Status: Authorised, recruitment pending. Decision date: 2025-02-03. Results received: No. Last updated: 2025-02-03.

Condition(s): ADHD

Source: https://euclinicaltrials.eu/ctis-public/view/2024-517956-36-00